EU clinical trial 2024-515229-26-00: Double-blind, double-dummy, randomized, parallel-group, non-inferiority phase III trial on the efficacy and tolerability of 2 mg once daily vs. 1 mg twice daily budesonide orodispersible tablets for induction of histological remission in adults with eosinophilic esophagitis
Protocol code: BUL-8/EEA
Sponsor: Dr. Falk Pharma GmbH (Pharmaceutical company). Phase: Therapeutic confirmatory (Phase III). Countries: Germany (ongoing, recruiting), Portugal (ongoing, recruiting), Austria (ongoing, recruiting), Spain (ongoing, recruiting).
Therapeutic area(s): Diseases [C] - Digestive System Diseases [C06]
Gender: Female, Male. Age: 18-64 years, 65+ years. Enrolment: 234.
Status: Ongoing, recruiting. Start date (EU): 2021-05-21. Decision date: 2024-08-19. Results received: No. Last updated: 2026-04-20.
Decision dates by country: AT: 2024-09-15, PT: 2024-08-28, DE: 2024-08-19, ES: 2024-08-29

Condition(s): eosinophilic esophagitis
Product: Orodispersible tablet, BUL03, Jorveza 1 mg orodispersible tablets

Primary endpoint: Proportion of patients with histological remission
Endpoint(s): Change in the peak eos/mm2 hpf from baseline to week 6 (LOCF), Change in the severity of dysphagia, Change in the severity of odynophagia, Change of overall severity of EoE symptoms, Change in the total weekly Eosinophilic Esophagitis Activity Index

Source: https://euclinicaltrials.eu/ctis-public/view/2024-515229-26-00